EU clinical trial 2023-509725-49-00: The safety and antibody response of the nasal COV2 vaccine against the SARS-CoV-2 virus
Protocol code: COV2FIN11
Sponsor: Rokote Laboratories Finland Oy (Pharmaceutical company). Phase: Human Pharmacology (Phase I)- First administration to humans. Countries: Finland (ended).
Therapeutic area(s): Diseases [C] - Virus Diseases [C02]
Gender: Female, Male. Age: 18-64 years, 65+ years. Enrolment: 50.
Status: Ended. Start date (EU): 2025-01-27. End date (EU): 2025-08-06. Decision date: 2024-11-06. Results received: No. Last updated: 2025-08-06.
Decision dates by country: FI: 2025-01-27

Condition(s): Booster immunisation against COVID-19 disease caused by SARS-CoV-2 virus

Source: https://euclinicaltrials.eu/ctis-public/view/2023-509725-49-00